EU clinical trial 2023-509066-38-00: A Multicenter, RandomiZed, Active-ControLled Study to Evaluate the Safety and Tolerability of Two Blinded Doses of Abelacimab (MAA868) Compared with Open-Label Rivaroxaban in Patients with Atrial Fibrillation (AZALEA)
Protocol code: CMAA868A2204/ANT-006
Sponsor: Anthos Therapeutics Inc. (Pharmaceutical company). Phase: Therapeutic exploratory (Phase II). Countries: Czechia (ongoing, recruitment ended), Hungary (ongoing, recruitment ended), Poland (ongoing, recruitment ended).
Therapeutic area(s): Diseases [C] - Cardiovascular Diseases [C14]
Gender: Female, Male. Age: 18-64 years, 65+ years. Enrolment: 896.
Status: Ongoing, recruitment ended. Start date (EU): 2021-04-16. Decision date: 2024-02-07. Results received: No. Last updated: 2026-07-06.
Decision dates by country: CZ: 2024-02-07, HU: 2024-02-07, PL: 2024-02-14

Condition(s): Atrial Fibrillation
Product: Xarelto 15 mg film-coated tablets, Abelacimab 150 mg/ml solution for infusion, Xarelto 20 mg film-coated tablets

Primary endpoint: Time to first event of composite of International Society on Thrombosis and Haemostasis (ISTH)-defined major bleeding or CRNM bleeding events.
Endpoint(s): Time to first event ISTH-defined major bleeding events., Time to first event ISTH-defined major or minor bleeding events.

Source: https://euclinicaltrials.eu/ctis-public/view/2023-509066-38-00